EU clinical trial 2024-517521-25-00: Phase II-III study to assess the efficacy and safety of subcutaneous cluster-immunotherapy in patients suffering from grass pollen allergy
Protocol code: SC-3G2A
Sponsor: ROXALL Medizin GmbH (Pharmaceutical company). Phase: Phase II and Phase III (Integrated). Countries: Germany (ongoing, recruitment ended).
Therapeutic area(s): Diseases [C] - Immune System Diseases [C20]
Gender: Female, Male. Age: 18-64 years. Enrolment: 30.
Status: Ongoing, recruitment ended. Start date (EU): 2025-10-20. Decision date: 2025-08-18. Results received: No. Last updated: 2025-08-18.

Condition(s): Patients with moderate-to-severe allergic rhinitis/rhinoconjunctivitis due to grass pollen for at least two years according to the Allergic Rhinitis and its Impact on Asthma (ARIA) guideline (Bousquet et al., 2008)
Product: CLU-RX-PHL high dose, CLU-RX-PHL medium dose, Placebo preparation for subcutanoues use with appearance, smell, taste and excipients identical to verum, but without the active substance, i. e. allergen extract., CLU-RX-PHL low dose

Primary endpoint: The primary (efficacy) endpoint is defined as the absolute differences in mean CSMS (Combined Symptom and Medication Score) during Peak Grass Pollen Period (PGPP) of each active treatment group compared with placebo treatment group.
Endpoint(s): Absolute and relative differences in mean CSMS during the Grass Pollen Season (GPS) between active and placebo treatment groups., Absolute and relative differences in mean dSS during PGPP and GPS., Absolute and relative differences in the 6 mean individual symptom scores (4 nasal and 2 ocular) during PGPP and GPS., Absolute and relative differences in mean dMS during PGPP and GPS., Change in Global Rhinoconjunctivitis Discomfort with a 10.0-point Visuaobl Analogue Scale (VAS) between active and placebo treatment groups comparing basal and post-treatment scaling., Change in Rhinoconjunctivitis quality of life questionnaire (RQLQ) between active and placebo treatment groups comparing basal and post-treatment scoring, Well and severe days: A well day is defined as a day without administration of any rescue medication (dMS = 0) and with dSS < 0.34 (range 0-3). A severe day is defined (acc. to Pfaar et al. 2014) as a day with a single score = 3 in any of the six symptoms. Percentages of well and severe days will be calculated for each subject as the number of well or severe days in the PGPP and GPS in relation to the number of days comprising both period, Symptom-free days during PGPP and PGP are defined as the days with absence of symptoms, (dSS = 0), and without administration of any rescue medication (dMS = 0), expressed as percentage of days during the PGPP and GPS, titrated Nasal Provocation Test: To assess the efficacy of each dose of CLU-RX-PHL compared to placebo. Defined as % of patients with an increased dosing step and change in number of dosing steps needed to provoke a positive response in tNPT post-treatment compared with pre-treatment (i. e. any improvement) in each of the 4 treatment groups.This is based on the change of the response to nasal provocation (tNPT) from baseline to end of treatment.

Source: https://euclinicaltrials.eu/ctis-public/view/2024-517521-25-00